EU clinical trial 2024-519097-39-01: Ketamine for the treatment of depressive and negative symptoms in patients with schizophrenia: a randomized controlled cross-over pilot study.
Sponsor: Medical University Of Vienna (Educational Institution). Phase: Therapeutic confirmatory (Phase III). Countries: Austria (ongoing, recruiting).
Therapeutic area(s): Psychiatry and Psychology [F] - Mental Disorders [F03]
Gender: Female, Male. Age: 18-64 years. Enrolment: 20.
Status: Ongoing, recruiting. Start date (EU): 2022-06-23. Decision date: 2025-02-27. Results received: No. Last updated: 2025-02-27.

Condition(s): Negative and depressive symptoms in schizophrenia / schizoaffective disorder
Product: Dibondrin - Ampullen, Ketanest® S 25 mg/ml - Ampullen

Primary endpoint: Change from baseline in Brief Negative Symptoms Scale (BNSS) scores after two weeks of treatment with esketamine or active placebo (diphenhydramine), Change from baseline in Montgomery-Asberg Depression Rating Scale (MADRS) scores after two weeks of treatment with esketamine or active placebo

Source: https://euclinicaltrials.eu/ctis-public/view/2024-519097-39-01